EU clinical trial 2023-509458-77-00: Blood-borne assessment of stromal activation in esophageal adenocarcinoma to guide tocilizumab therapy: a randomized phase II proof-of-concept study (BASALT)
Sponsor: Amsterdam UMC (Hospital/Clinic/Other health care facility). Phase: Therapeutic exploratory (Phase II). Countries: Netherlands (ongoing, recruitment ended).
Therapeutic area(s): Diseases [C] - Neoplasms [C04]
Gender: Female, Male. Age: 18-64 years, 65+ years. Enrolment: 3.
Status: Ongoing, recruitment ended. Start date (EU): 2021-01-04. Decision date: 2024-04-08. Results received: No. Last updated: 2024-04-08.

Condition(s): Esophageal adenocarcinoma, esophageal cancer
Product: TOCILIZUMAB

Primary endpoint: The primary endpoint is pathological response to chemoradiotherapy according to the Mandard criteria.
Endpoint(s): Secondary endpoints are: • R0 resection rate. • Progression free survival • Overall survival • IL-6-STAT3 pathway inhibition based on gene expression analysis • pSTAT3 and stromal abundance in formalin-fixed paraffin-embedded tumor tissue • Levels of IL-6 in serum. • Levels of ADAM12 in tumor biopsies and serum in relation to pathological response according to the Mandard criteria. • Incidence and severity of toxicity defined according to CTCAE v5.0 and Radiation Oncology Group (RTOG) criteria., • Incidence and severity of post-operative complications according to the Dindo classification. • Percentage completion of chemotherapy and radiation treatment • Percentage withdrawal rate from surgery due to tocilizumab related complications • Percentage delay of surgery due to tocilizumab related complications

Source: https://euclinicaltrials.eu/ctis-public/view/2023-509458-77-00